EU clinical trial 2024-510620-39-00: An Open-label, Randomized, Phase 3 Study of MK-6482 in Combination with Lenvatinib (MK-7902) vs Cabozantinib for Treatment in Participants with Advanced Renal Cell Carcinoma Who Have Progressed After Prior Anti-PD-1/L1 Therapy
Protocol code: MK-6482-011
Sponsor: Merck Sharp & Dohme LLC (Pharmaceutical company). Phase: Therapeutic confirmatory (Phase III). Countries: Austria (ongoing, recruitment ended), Ireland (ongoing, recruitment ended), Belgium (ongoing, recruitment ended), Romania (ongoing, recruitment ended), Poland (ongoing, recruitment ended), Germany (ongoing, recruitment ended), Spain (ongoing, recruitment ended), Czechia (ongoing, recruitment ended), Greece (ongoing, recruitment ended), Finland (ongoing, recruitment ended), France (ongoing, recruitment ended), Netherlands (ongoing, recruitment ended), Italy (ongoing, recruitment ended).
Therapeutic area(s): Diseases [C] - Neoplasms [C04]
Gender: Female, Male. Age: 18-64 years, 65+ years. Enrolment: 361.
Status: Ongoing, recruitment ended. Start date (EU): 2021-04-19. Decision date: 2024-03-21. Results received: No. Last updated: 2026-04-14.
Decision dates by country: FI: 2024-03-22, GR: 2024-05-13, IE: 2024-03-21, NL: 2024-03-21, CZ: 2024-03-27, FR: 2024-05-24, IT: 2024-03-28, DE: 2024-03-25, PL: 2024-04-02, ES: 2024-04-08, RO: 2024-03-28, BE: 2024-04-10, AT: 2024-04-08

Condition(s): Advanced RCC with clear cell component
Product: Belzutifan, CABOZANTINIB, Lenvatinib, Lenvatinib

Primary endpoint: Progression-Free Survival (PFS) per Response Evaluation Criteria in Solid Tumors Version 1.1 (RECIST 1.1) as Assessed by Blinded Independent Central Review (BICR), Overall Survival (OS)
Endpoint(s): Objective Response Rate (ORR) per Response Evaluation Criteria in Solid Tumors Version 1.1 (RECIST 1.1) as Assessed by Blinded Independent Central Review (BICR), Duration of Response (DOR) per Response Evaluation Criteria in Solid Tumors Version 1.1 (RECIST 1.1) as Assessed by Blinded Independent Central Review (BICR), Number of Participants Who Experienced One or More Adverse Events (AEs), Number of Participants Who Discontinued Study Treatment Due to an Adverse Event (AE)

Source: https://euclinicaltrials.eu/ctis-public/view/2024-510620-39-00